EU clinical trial 2023-509672-42-00: A Multinational, Multicenter Study With an Open-Label Phase 1b and a Randomized, Double-Blind, Placebo-Controlled Phase 3 Followed by an Open-Label Extension to Assess the Efficacy, Safety, Tolerability, and Pharmacokinetics of Radiprodil in Participants With GRIN-Related Neurodevelopmental Disorder
Protocol code: RAD-GRIN-101
Sponsor: Grin Therapeutics Inc. (Pharmaceutical company). Phase: Therapeutic confirmatory (Phase III). Countries: Germany (ongoing, recruiting), Netherlands (ongoing, recruiting), Italy (ongoing, recruiting), Spain (ongoing, recruiting), France (ongoing, recruiting), Poland (authorised, recruiting), Belgium (ongoing, recruiting), Slovenia (ongoing, recruiting).
Therapeutic area(s): Diseases [C] - Nervous System Diseases [C10]
Gender: Female, Male. Age: 0-17 years, 18-64 years. Enrolment: 56.
Start date (EU): 2023-02-02. Decision date: 2024-01-03. Results received: No. Last updated: 2026-08-06.
Decision dates by country: FR: 2025-01-10, IT: 2024-01-09, PL: 2025-01-27, SI: 2025-01-28, NL: 2024-01-15, BE: 2024-11-08, ES: 2024-01-03, DE: 2024-01-09

Condition(s): GRIN-related neurodevelopmental disorder
Product: Radiprodil, Radiprodil, matching Radiprodil oral suspension, Radiprodil

Primary endpoint: PART A – PHASE 1b: • Adverse events (AEs), serious adverse events (SAEs), and adverse drug reactions (ADRs) (frequency, type, severity, and duration); • Changes in vital signs; • Physical examination findings; • 12-lead electrocardiogram (ECG) findings: • Clinically significant changes in laboratory parameters; • Emergence of new seizure types; • Occurrence of suicidal ideation or behavior, PART A – PHASE 1b: Plasma concentrations of radiprodil at predefined timepoints, PART A – PHASE 3 RANDOMIZED QUALIFYING SEIZURES COHORT: Countable motor seizure frequency (per 28 days) during the Maintenance Period (Weeks 1 through 12), as captured in the daily seizure eDiary, PART A – PHASE 3 RANDOMIZED WITHOUT QUALIFYING SEIZURES AUXILIARY COHORT: Change from baseline to end of Maintenance Period (Week 24) in the ABC-2C irritability subscale score, PART B – OLE STUDY: AEs, SAEs, and ADRs (frequency, type, severity, and duration)
Endpoint(s): PART A – PHASE 1b: • Change from baseline to End of Treatment (EOT) in seizure frequency from daily seizure electronic diary (eDiary); • Percent change from baseline to EOT in video electroencephalogram (V EEG) seizure burden (eg, seizure type, severity, and frequency recorded during V EEGs); • Seizure-free days and longest period with no seizures, PART A – PHASE 1b: Change from baseline to EOT in behavioral features as measured by the aberrant behavior checklist-community (ABC 2C), as well as other disorder features as measured by gross motor function measure (GMFM), sleep disturbance scale for children (SDSC), quality of life (Pediatric Quality of Life Inventory [PedsQL]), Caregiver Burden Inventory (CBI), and global impression (Caregiver Global Impression of Change [CaGI C]), and Clinical Global Impression of Change [CGI-C] scales), PART A – PHASE 3 RANDOMIZED QUALIFYING SEIZURES COHORT: Proportion of participants with ≥50% reduction in CMS frequency (per 28 days) from baseline (the last 4 weeks prior to randomization) to the entire Maintenance Period (Weeks 1 through 12), as captured in the daily seizure eDiary, PART A – PHASE 3 RANDOMIZED QUALIFYING SEIZURES COHORT: Change in the number of CMS-free days (per 28 days) from baseline (the last 4 weeks prior to randomization) to the entire Maintenance Period (Weeks 1 through 12), as captured in the daily seizure eDiary, PART A – PHASE 3 RANDOMIZED QUALIFYING SEIZURES COHORT: Cumulative distribution of percent reduction in seizure frequency from Baseline to the entire Maintenance Period (Weeks 1 through 12), PART A – PHASE 3 RANDOMIZED QUALIFYING SEIZURES COHORT: GRIN-NDD-specific CGI-C (GRIN-CGI-C) evaluated at the end of the Maintenance Period (Week 12) relative to baseline for relevant domains, including expressive communication, receptive communication, fine motor, gross motor, and dysregulated behavior, PART A – PHASE 3 RANDOMIZED QUALIFYING SEIZURES COHORT: Change from baseline to the end of the Maintenance Period (Week 12) in the ABC 2C irritability subscale score, PART A – PHASE 3 RANDOMIZED QUALIFYING SEIZURES COHORT: Change from baseline to the end of the Maintenance Period (Week 12) in the Vineland Adaptive Behavior Scale, Third Edition (VABS-3) Daily Living personal subdomain score, PART A – PHASE 3 RANDOMIZED QUALIFYING SEIZURES COHORT: Change from baseline to the end of the Maintenance Period (Week 12) in quality of life as measured by the PedsQL, PART A – PHASE 3 RANDOMIZED WITHOUT QUALIFYING SEIZURES AUXILIARY COHORT: GRIN-CGI-C evaluated at the end of the Maintenance Period (Week 24) relative to baseline for relevant domains, including expressive communication, receptive communication, fine motor, gross motor, and dysregulated behavior, PART A – PHASE 3 RANDOMIZED WITHOUT QUALIFYING SEIZURES AUXILIARY COHORT: Change from baseline to the end of the Maintenance Period (Week 24) in the VABS-3 Daily Living personal subdomain score, PART A – PHASE 3 RANDOMIZED WITHOUT QUALIFYING SEIZURES AUXILIARY COHORT: Change from baseline to the end of the Maintenance Period (Week 24) in quality of life as measured by the PedsQL, PART A – PHASE 3 RANDOMIZED WITHOUT QUALIFYING SEIZURES AUXILIARY COHORT: AEs, SAEs, and ADRs (frequency, type, severity, and duration), PART B – OLE STUDY: Percent change in the CMS frequency per 28 days from baseline to each 12-week interval in the open-label extension (OLE) through the end of the OLE, as captured in the daily seizure eDiary, PART B – OLE STUDY: Change in the number of CMS-free days per 28 days from baseline to each 12-week interval in the OLE through the end of the OLE, as captured in the daily seizure eDiary, PART B – OLE STUDY: Change from baseline to each open-label treatment visit through the end of open-label treatment in the ABC-2C irritability subscale score, the VABS-3 Daily Living personal subdomain score, the PedsQL, and the GRIN-CGI-C scale for relevant domains (including expressive communication, receptive communication, fine motor, gross motor, and dysregulated behavior) Note: VABS-3 and GRIN-CGI-C scales to be assessed for Phase 3 participants only

Source: https://euclinicaltrials.eu/ctis-public/view/2023-509672-42-00